EU clinical trial 2025-521967-11-00: Electrophysiological analysis of Gamma-Hydroxybutyrate-induced sleep in intensive care patients: A Pilot Double-Blind Randomized Controlled Trial.(GAMMA-SLEEP)
Protocol code: APHP241595
Sponsor: Assistance Publique Hopitaux De Paris (Hospital/Clinic/Other health care facility). Phase: Therapeutic exploratory (Phase II). Countries: France (authorised, recruitment pending).
Therapeutic area(s): Psychiatry and Psychology [F] - Mental Disorders [F03]
Gender: Female, Male. Age: 18-64 years, 65+ years. Enrolment: 24.
Status: Authorised, recruitment pending. Decision date: 2026-04-28. Results received: No. Last updated: 2026-06-10.

Condition(s): The study population includes adult ICU patients with a hospitalization of more than 48 hours. We have chosen to include patients with or without mechanical ventilation, as sleep disorders affect all ICU patients after 48 hours.
Product: GAMMA-OH 200 mg/ml, solution injectable (IV), NaCl 0.9%

Primary endpoint: The primary endpoint is the duration (in minutes) of deep slow-wave sleep (N3 stage) based on polysomnographic recordings
Endpoint(s): 1) Quantity and quality of nocturnal sleep. •Sleep onset latency • Total sleep time •Duration and percentage of N1 stage (sleep onset). • Duration and percentage of N2 stage (light slow-wave sleep). • Percentage of N3 stage (deep slow-wave sleep). • Duration and percentage of Rapid Eye Movement sleep (REM). • Quantification of intra-sleep wakefulness. • Quantification of atypical sleep. •Quantification of pathological wakefulness •Quantification of micro-awakenings. • Sleep efficiency, Quality of daytime alertness: • Daytime vigilance score (Karolinska Sleepiness scale) • Average sleep latency during the Maintenance of Wakefulness Test (MWT) the morning after the study night, Analgesic consumption and participation in rehabilitation: •Morphine equivalent quantification •Assessment of rehabilitation participation, Evaluation of adverse events, particularly hypokalemia, hypernatremia, mental confusion, agitation, arterial hypertension, or bradycardia

Source: https://euclinicaltrials.eu/ctis-public/view/2025-521967-11-00